EU clinical trial 2024-517017-33-00: EPI/HIS-trial
Sponsor: Medical University Of Vienna (Educational Institution). Phase: Human Pharmacology (Phase I)- Other. Countries: Austria (ongoing, recruiting).
Therapeutic area(s): Phenomena and Processes [G] - Circulatory and Respiratory Physiological Phenomena [G09]
Gender: Female, Male. Age: 18-64 years. Enrolment: 22.
Status: Ongoing, recruiting. Start date (EU): 2023-04-04. Decision date: 2024-12-11. Results received: No. Last updated: 2026-07-17.

Condition(s): No medical condition, it is a study in healthy volunteers

Source: https://euclinicaltrials.eu/ctis-public/view/2024-517017-33-00